EU clinical trial 2025-522567-15-00: A Phase 3, Randomized, Multicenter, Double-Blind, Placebo-Controlled Trial to Evaluate the Efficacy, Safety, Tolerability, and Pharmacokinetics of Zasocitinib in Pediatric Participants Aged 4 to Less Than 18 Years With Moderate-to-Severe Plaque Psoriasis
Protocol code: TAK-279-PsO-3006
Sponsor: Takeda Development Center Americas Inc. (Pharmaceutical company). Phase: Therapeutic confirmatory (Phase III). Countries: Spain (authorised, recruiting), Poland (ongoing, recruiting), Germany (ongoing, recruiting), Italy (authorised, recruiting).
Therapeutic area(s): Diseases [C] - Skin and Connective Tissue Diseases [C17]
Gender: Female, Male. Age: 0-17 years. Enrolment: 54.
Start date (EU): 2026-04-28. Decision date: 2026-04-01. Results received: No. Last updated: 2026-06-22.
Decision dates by country: DE: 2026-04-07, IT: 2026-04-01, ES: 2026-04-06, PL: 2026-04-03

Condition(s): Plaque Psoriasis
Product: ZASOCITINIB, Matching Placebo for TAK-279

Primary endpoint: Part A: Coprimary Endpoints (vs Placebo) at Week 16 • sPGA 0/1 response: Proportion of participants achieving an sPGA of clear (0) or almost clear (1) with a ≥2-point decrease from baseline. • PASI-75 response: Proportion of participants achieving ≥75% improvement from baseline in PASI score. Part A Cohort 1: Includes adolescent participants aged 12 to <18 years. Part A Cohort 2: Includes children participants aged 4 to <12 years., Part B: PK Primary Endpoints • PK parameters (that is Cmax, Tmax, AUC0-Last) of zasocitinib on Day 7. Part B: Includes only children participants aged 4 to <12 years. Part B participants will be separate from Part A Cohort 2 participants.
Endpoint(s): Part A: Key Secondary Efficacy Endpoints (vs Placebo) at Week 16 • PASI-90 response: Proportion of participants achieving PASI-90. • Enhanced sPGA response: Proportion of participants achieving an sPGA of clear (0). • PASI-100 response: Proportion of participants achieving PASI-100., Part A: Additional Secondary Efficacy Endpoints (vs Placebo) at Week 16 • ssPGA response: Proportion of participants achieving an ssPGA of clear (0) or almost clear (1) with a ≥2-point decrease from baseline for participants with a baseline ssPGA ≥3. • Change and percent change from baseline in BSA affected by psoriasis., • DLQI response: Proportion of participants with a DLQI score of 0/1 (for participants with a baseline DLQI score ≥2). • CDLQI response: Proportion of participants with a CDLQI score of 0/1 (for participants with a baseline CDLQI score ≥2). • Change from baseline in DLQI. • Change from baseline in CDLQI., Part A (Cohort 1 only): Additional Secondary Efficacy Endpoints (vs Placebo) at Week 16 • Itch NRS response: Proportions of participants achieving a ≥4-point improvement in Itch NRS for participants in Cohort 1 who had an itch NRS ≥4 at baseline. • Change and percent change from baseline in Itch NRS for participants in Cohort 1., Parts A and B: Additional Secondary Efficacy Endpoints at Each Scheduled Visit Over the Duration of the Open-Label Period • PASI-75 response: Proportion of participants achieving PASI-75. • PASI-90 response: Proportion of participants achieving PASI-90. • PASI-100 response: Proportion of participants achieving PASI-100., • sPGA 0/1 response: Proportion of participants achieving an sPGA of clear (0) or almost clear (1) with a ≥2-point decrease from baseline. • Enhanced sPGA response: Proportion of participants achieving an sPGA of clear (0)., • ssPGA response: Proportion of participants achieving an ssPGA of clear (0) or almost clear (1) with a ≥2-point decrease from baseline for participants with a baseline ssPGA ≥3. • Change and percent change from baseline in BSA affected by psoriasis., • DLQI response: Proportion of participants with a DLQI score of 0/1 (for participants with a baseline DLQI score ≥2). • CDLQI response: Proportion of participants with a CDLQI score of 0/1 (for participants with a baseline CDLQI score ≥2)., • Change from baseline in DLQI. • Change from baseline in CDLQI., Part A (Cohort 1 only): Additional Secondary Efficacy Endpoints at Each Scheduled Visit Over the Duration of the Open- Label Period • Itch NRS responses: Proportions of participants achieving a ≥4-point improvement in Itch NRS for participants in Cohort 1 who had an itch NRS ≥4 at baseline. • Change and percent change from baseline in Itch NRS for participants in Cohort 1., Part A: Additional Secondary PK Endpoint • Plasma concentrations of zasocitinib in participants receiving active treatment., Part B: Additional Secondary Endpoint • Acceptability/palatability assessment scores.

Source: https://euclinicaltrials.eu/ctis-public/view/2025-522567-15-00